EU clinical trial 2024-515333-14-03: Targeting inflammation to reduce 90-day and 1-year postoperative severe morbidity in patients with unfavorable inflammatory profile undergoing oncologic surgery (POST CARE Trial)
Sponsor: Fondazione IRCCS Istituto Nazionale Dei Tumori (Hospital/Clinic/Other health care facility). Phase: Therapeutic exploratory (Phase II). Countries: Italy (authorised, recruitment pending).
Therapeutic area(s): Diseases [C] - Neoplasms [C04]
Gender: Female, Male. Age: 18-64 years, 65+ years. Enrolment: 83.
Status: Authorised, recruitment pending. Decision date: 2025-12-17. Results received: No. Last updated: 2025-12-17.

Condition(s): Patients scheduled for major surgery for oncologic indication
Product: Acido Acetilsalicilico Teva Italia 100 mg compresse gastroresistenti, Tora-Dol 30 mg/ml soluzione iniettabile

Primary endpoint: test the clinical efficacy and the safety of the experimental treatment

Source: https://euclinicaltrials.eu/ctis-public/view/2024-515333-14-03